EU clinical trial 2023-504618-31-00: Capsaicin 179 mg patch versus oral Duloxetine in patients with chemotherapy-induced peripheral neuropathy: a phase 3 randomized multicentric open-label study (CAPNEUCHIM)
Protocol code: ICO-2022-02
Sponsor: Institut De Cancerologie De L Ouest (Hospital/Clinic/Other health care facility). Phase: Therapeutic confirmatory (Phase III). Countries: France (ongoing, recruiting).
Therapeutic area(s): Diseases [C] - Neoplasms [C04]; Diseases [C] - Pathological Conditions, Signs and Symptoms [C23]
Gender: Female, Male. Age: 18-64 years, 65+ years. Enrolment: 274.
Status: Ongoing, recruiting. Start date (EU): 2023-10-20. Decision date: 2023-08-21. Results received: No. Last updated: 2026-05-27.

Condition(s): Chemotherapy induced peripheral neuropathy (CIPN)
Product: CAPSAICIN, DULOXETINE, DULOXETINE

Primary endpoint: Percentage of painful CIPN patients experiencing a 30% improvement in their average pain severity score at 6 weeks compared to baseline (measured on day 1 of week 6)
Endpoint(s): a) Safety will be assessed according to the CTC-AE v5.0, at week 6, week 12, week 19 and week 26, b) Efficacy on non-painful sensory symptoms (tingling, numbness) will be assessed by the rate of patients improving by at last 30% their sensory scale scores from the quality of life questionnaire-chemotherapy-induced peripheral neuropathy (QLQ-CIPN20 and NPSI), between baseline and week 6, week 12, week 19 and week26, c) Quality of life will be assessed by QLQ C30 and the SF (short form)-12 quality of life scale at baseline, week 6, week 12, week 19 and week 26. SF 12 is an abbreviated version of SF-36, a generic Health Related Quality of Life (HRQoL) questionnaire, d) Functional interference will be assessed using the Brief Pain Inventory-Short Form (BPI-SF) at baseline, week 6, week 12, week 19 and week 26, e) Global improvement of CIPN will be assessed by the total score of the EORTC QLQ-CIPN20 at baseline, week 6, week 12, week 19 and week 26, f) Global satisfaction of the patient will be assessed by the Patient Global Impression of Change (PGIC) reflecting patient's belief about treatment efficacy (evaluated at week 6, week 12, week 19 and week 26), g) Demonstration of improved efficacy and safety after repeat, applications of capsaicin will be assessed by paired comparison of the different scores between baseline, week 6, week 12, week 19 and week 26, h) The psychometric properties will be assessed from the French-CIPN20 - at baseline in all patients for structural validity and known-group comparisons for structural validity - at inclusion and at W0 (patch application) in patients randomised in the experimental arm for reliability

Source: https://euclinicaltrials.eu/ctis-public/view/2023-504618-31-00